EU clinical trial 2024-512798-29-00: An Open-Label, Multicenter, Prospective, Interventional Study to Assess the Role of Pancreatic Enzyme Replacement Therapy (PERT) (Creon® 35,000) in Patients with Pancreatic Exocrine Insufficiency (PEI) after Pancreatic Surgery
Protocol code: PANC-CAP-3001
Sponsor: MEDA Pharma GmbH & Co. KG (Pharmaceutical company). Phase: Therapeutic confirmatory (Phase III). Countries: Germany (ongoing, recruiting), Poland (ongoing, recruiting), Spain (ongoing, recruiting), Austria (authorised, recruitment pending).
Therapeutic area(s): Diseases [C] - Digestive System Diseases [C06]
Gender: Female, Male. Age: 18-64 years, 65+ years. Enrolment: 90.
Start date (EU): 2025-01-07. Decision date: 2024-11-05. Results received: No. Last updated: 2026-07-10.
Decision dates by country: ES: 2024-11-11, PL: 2024-11-11, AT: 2026-07-10, DE: 2024-11-05

Condition(s): Male and female patients aged ≥ 18 to ≤ 85 years with a total pancreatectomy with Pancreatic Exocrine Insufficiency (PEI).
Product: Kreon 35 000 Ph. Eur. Lipase Einheiten, magensaftresistente Hartkapseln

Primary endpoint: Percentage of patients treated with higher than approved final treatment doses.
Endpoint(s): CGI (investigator), Nutritional laboratory parameters, Diabetes parameters (glucose and HbA1c levels, insulin doses), Clinical symptoms (abdominal pain, flatulence, stool consistency; diary), stool frequency, average daily stool frequency during treatment period (diary), time course, Body Mass Index (BMI) and body weight, Improvement in Quality of Life (QoL), Pancreatic Exocrine Insufficiency Questionnaire (PEI-Q), change from baseline to end of treatment, Evaluation of vital signs, Incidence of Adverse Events (AEs) – PERT related

Source: https://euclinicaltrials.eu/ctis-public/view/2024-512798-29-00